EU clinical trial 2023-505924-71-00: Phase 2, Open label Study of DS-1062a, an Anti-TROP-2-Antibody-Drug Conjugate (ADC), in patients with advanced and/or unresectable Non-Small Cell Lung Cancer (NSCLC), with biomarker analysis to characterize response to therapy_ ICARUS LUNG 01
Protocol code: CSET 2020/3187
Sponsor: Institut Gustave Roussy (Hospital/Clinic/Other health care facility). Phase: Therapeutic exploratory (Phase II). Countries: France (ongoing, recruiting).
Therapeutic area(s): Diseases [C] - Neoplasms [C04]
Gender: Female, Male. Age: 18-64 years, 65+ years. Enrolment: 100.
Status: Ongoing, recruiting. Start date (EU): 2021-05-12. Decision date: 2024-09-20. Results received: No. Last updated: 2025-10-27.

Condition(s): Adult patients with metastatic and/or unresectable Non-Small Cell Lung Cancer (NSCLC) who progressed on at least one line and not more than three lines of prior therapy for metastatic/unresectable NSCLC

Source: https://euclinicaltrials.eu/ctis-public/view/2023-505924-71-00